EU clinical trial 2023-509981-39-00: A phase 2B, randomized, double-blind, parallel group, placebo-controlled study to evaluate the efficacy and safety of Rezpegaldesleukin in the treatment of severe to very severe alopecia areata in adult patients (Rezolve AA)
Protocol code: 23-358-06
Sponsor: Nektar Therapeutics (Pharmaceutical company). Phase: Therapeutic exploratory (Phase II). Countries: Poland (ongoing, recruitment ended).
Therapeutic area(s): Diseases [C] - Skin and Connective Tissue Diseases [C17]; Diseases [C] - Immune System Diseases [C20]
Gender: Female, Male. Age: 18-64 years, 65+ years. Enrolment: 38.
Status: Ongoing, recruitment ended. Start date (EU): 2024-11-20. Decision date: 2024-11-18. Results received: No. Last updated: 2025-09-12.

Condition(s): Alopecia Areata
Product: NKTR-358, Placebo

Primary endpoint: Percent change from baseline in Severity of Alopecia Tool (SALT) score at Week 36
Endpoint(s): Percent change from baseline in SALT score at Weeks 12, 16, 20, 24, 28 and 32, Proportion of patients achieving improvement in SALT (≥50%, ≥75%, and ≥90%) relative to their baseline score (SALT50, SALT75 and SALT90) at Weeks 12, 16, 20, 24, 28, 32, and 36, Proportion of patients achieving an absolute SALT score ≤10, ≤20, ≤30, ≤50 relative to their baseline score at Weeks 12, 16, 20, 24, 28, 32, and 36

Source: https://euclinicaltrials.eu/ctis-public/view/2023-509981-39-00